EU clinical trial 2023-510297-14-00: Safety and efficacy of low-dose interleukin-2 therapy in chronic inflammatory barrier diseases (IL-2-ID): a single-center, randomized, double-blind and placebo-controlled phase 2 clinical basket trial
Protocol code: EXC2167-5
Sponsor: Universitaetsklinikum Schleswig-Holstein AöR (Hospital/Clinic/Other health care facility). Phase: Therapeutic exploratory (Phase II). Countries: Germany (ongoing, recruiting).
Therapeutic area(s): Diseases [C] - Skin and Connective Tissue Diseases [C17]; Diseases [C] - Immune System Diseases [C20]
Gender: Female, Male. Age: 18-64 years, 65+ years. Enrolment: 112.
Status: Ongoing, recruiting. Start date (EU): 2024-12-27. Decision date: 2024-04-04. Results received: No. Last updated: 2025-01-15.

Condition(s): Primary Sclerosing Cholangitis (PSC), Mucous Membrane Pemphigoid, Polymyositis/ Dermatomyositis, Pemphigus vulgaris / foliaceus
Product: PROLEUKIN® S 18 x 106 IE Pulver zur Herstellung einer Injektionslösung oder Infusionslösung, GLUCOSE

Primary endpoint: The IL-2 induced Treg response, defined as the increase in absolute numbers of CD3+CD4+FoxP3+CD127loCD25hi Treg according to the area under the curve (AUC) obtained between day 1 and day 57,, The clinical response at day 57 assessed by absolute changes in disease-specific and z-standardized disease activity measures from day 1 to day 57. The respective disease activity measures for each of the investigated diseases are the Pemphigus Disease Area Index (PDAI), Mucous Membrane Pemphigoid Disease Area Index (MMPDAI), plasma levels of Creatine-Kinase (CK) or Alkaline Phosphatase (AP).
Endpoint(s): The clinical response at day 57, assessed by absolute and relative changes in disease-specific measures (PDAI, MMPDAI, CK, AP) between day 1 and day 57 compared with placebo.

Source: https://euclinicaltrials.eu/ctis-public/view/2023-510297-14-00